EU clinical trial 2024-520441-23-00: Efficacy and safety of NNC0487-0111 s.c. once-weekly in participants with overweight or obesity, and type 2 diabetes (AMAZE 2)
Protocol code: NN9490-8024
Sponsor: Novo Nordisk A/S (Pharmaceutical company). Phase: Therapeutic confirmatory (Phase III). Countries: Italy (ongoing, recruiting), Croatia (ongoing, recruiting), Hungary (not authorised), Slovakia (ongoing, recruiting), Romania (ongoing, recruiting).
Therapeutic area(s): Diseases [C] - Nutritional and Metabolic Diseases [C18]
Gender: Female, Male. Age: 18-64 years, 65+ years. Enrolment: 265.
Start date (EU): 2026-05-13. Decision date: 2026-05-04. Results received: No. Last updated: 2026-05-11.
Decision dates by country: HR: 2026-05-11, HU: 2026-05-11, IT: 2026-05-06, RO: 2026-05-11, SK: 2026-05-04

Condition(s): Overweight or obesity, and type 2 diabetes
Product: NNC0487-0111 B 10146, Placebo, NNC0487-0111 B 10141, NNC0487-0111 B 10142, NNC0487-0111 B 10143, NNC0487-0111 B 10145, NNC0487-0111 B 10144

Primary endpoint: Relative change in body weight
Endpoint(s): CCI, CCI, CCI, Change in waist circumference, Change in haemoglobin A1c (HbA1c), Change in systolic blood pressure (SBP), Change in Impact of Weight on Quality of Life-Lite Clinical Trials Version (IWQOL-Lite-CT) physical function score, CCI, Change in SF-36v2® Health Survey Acute (SF-36v2 Acute) physical functioning scorea, CCI, Change in body weight, Change in body mass index (BMI), Change in IWQOL-Lite-CT Physical Psychosocial Total score, CCI, CCI, CCI, CCI, CCI, Achievement of HbA1c < 7.0% (Yes/No), Achievement of HbA1c ≤ 6.5% (Yes/No), Achievement of HbA1c < 5.7% (Yes/No), Change in fasting plasma glucose (FPG), Change in fasting insulin, Change in urinary albumin-to-creatinine ratio (UACR), Change in diastolic blood pressure, Change in lipids: Total cholesterol High-density lipoprotein (HDL) cholesterol Low-density lipoprotein (LDL) cholesterol Very low-density lipoprotein (VLDL) cholesterol Non-HDL cholesterol TriglycerideS, Change in high-sensitivity C-reactive protein (hsCRP), CCI, CCI, CCI, CCI, CCI, CCI, Number of Treatment Emergent Adverse Events (TEAEs), Number of Treatment Emergent Serious Adverse Events (TESAEs), Number of Treatment Emergent Adverse Events (TEAEs) leading to permanent treatment discontinuation, Number of treatment emergent clinically significant hypoglycaemic episodes (level 2) (< 3.0 mmol/L (54 mg/dL), confirmed by a blood glucose (BG) meter), Number of treatment emergent severe hypoglycaemic episodes (level 3): hypoglycaemia associated with severe cognitive impairment requiring external assistance for recovery, with no specific glucose threshold

Source: https://euclinicaltrials.eu/ctis-public/view/2024-520441-23-00